EU clinical trial 2023-505901-17-00: A Phase 3, prospective, randomized, multi-center, intervention trial of early intensification in AML patients bearing FLT3 mutations based on peripheral blast clearance. A MYNERVA-GIMEMA study. AMELIORATE (AML Early IntensificatiOn based on peRipheral blAsT clEarance). AML1919
Protocol code: GIMEMA AML1919
Sponsor: Fondazione Gimema Franco Mandelli Onlus (Health care). Phase: Therapeutic confirmatory (Phase III). Countries: Italy (ongoing, recruiting).
Therapeutic area(s): Diseases [C] - Hemic and Lymphatic Diseases [C15]
Gender: Female, Male. Age: 18-64 years, 65+ years. Enrolment: 172.
Status: Ongoing, recruiting. Start date (EU): 2020-04-24. Decision date: 2024-01-12. Results received: No. Last updated: 2026-05-20.

Condition(s): Acute Myeloid Leukemia (LMA) with FLT3 mutation
Product: MIDOSTAURIN, ARACYTIN 500 mg/10 ml Polvere e Solvente per Soluzione Iniettabile, DAUNORUBICIN HYDROCHLORIDE

Primary endpoint: The primary endpoint is to evaluate the event-free survival (EFS) at 2 years of an experimental intensified PBC-driven arm in comparison to a standard therapeutic regimen in patients with FLT3+ AML and low peripheral blood clearance (PBC) measured at day 4.
Endpoint(s): Feasibility and safety of PBC-driven treatment: 1. Adverse events rate according to CTCAE criteria according to PBC and treatment arm 2. Rate of deaths in aplasia as per ELN 2017 definition according to PBC and treatment arm 3. Days to neutrophils recovery after induction and consolidation cycles according to PBC and treatment arm 4. Days to platelets recovery after induction and consolidation cycles according to PBC and treatment arm, Efficacy, in lowPBC-patients, of PBC-driven treatmentaccording to treatment arm:1.CR rate as perELN2017after1st induction cycle 2.CR rate as perELN2017after2cycles 3.Disease-free surv. as per ELN2017 4.Overall surv. as per ELN2017 5.Cumulative incidence of relapse and Treatment-related mortality 6.MRD at pre-def. time-points as per ELN2017according to PBC and treatment arm 7.Actual rate of patients receiving allogeneic transplant in first CR and with active disease according to PBC and tx arm, Evaluation of outcome for PBC-high patients treated per protocol (standard) and in comparison, with PBC-low treated as per randomization (standard vs experimental), and according to PBC and treatment arm: 1.CRrate as perELN2017after 1°induction cycle 2.CRrate as perELN2017after2cycles 3.DFS as per ELN2017 4.OS as per ELN2017 5.CIR and TRM 6. MRD at defined TPs as per ELN2017 7. actual rate of pz receiving allo HSCT in 1° CR and with active disease

Source: https://euclinicaltrials.eu/ctis-public/view/2023-505901-17-00